EU clinical trial 2024-511401-40-00: Investigating the role of JAK inhibition in achieving and maintaining disease remission in psoriatic arthritis (PsA).
Protocol code: BN001/S63343
Sponsor: UZ Leuven (Hospital/Clinic/Other health care facility). Phase: Therapeutic use (Phase IV). Countries: Belgium (ended).
Therapeutic area(s): Diseases [C] - Musculoskeletal Diseases [C05]
Gender: Female, Male. Age: 18-64 years, 65+ years. Enrolment: 20.
Status: Ended. Start date (EU): 2020-03-03. End date (EU): 2025-12-09. Decision date: 2024-04-03. Results received: No. Last updated: 2024-04-03.

Condition(s): Psoriatic Arthritis
Product: XELJANZ 5 mg film-coated tablets

Primary endpoint: - The proportion of patients achieving a status of clinical remission at week 24.
Endpoint(s): - The proportion of patients in drug-free remission at week 52 and week 104., - Time to relapse in patients experiencing a flare after treatment cessation., - The evolution of arthritis, dactylitis, enthesitis and skin involvement at week 4, week 12, week 24, week 28, week 52, week 76 and week 104, measured by : SJC66/TJC68; Dactylitis severity score; Leeds enthesitis index; BSA, - The evolution of patient-reported outcomes at week 4, week 12, week 24, week 28, week 52, week 76 and week 104: PGA; Health Assessment Questionnaire – disability index (HAQ); Short Form-36 physical functioning domain(SF-36); EuroQol 5- dimension Health state Profile (EQ-5D); PsA Impact of Disease (PsAID), - Percentage of patients achieving the PsA response criteria (PsARC), minimal disease activity (MDA) and 85% change in Disease activity (DAPSA) at week 12, week 24, week 52, week 76 and week 104, - Radiographic progression at week 52 and week 104

Source: https://euclinicaltrials.eu/ctis-public/view/2024-511401-40-00